EU clinical trial 2024-512333-33-00: AmaNtadine for NeuroenhancEment in acutE patients Study - A prospective pilot proof of concept phase IIb study in intensive and intermediate care unit patients (ANNES)
Protocol code: 2021-10
Sponsor: Universitaetsklinikum Tuebingen AöR (Hospital/Clinic/Other health care facility). Phase: Therapeutic exploratory (Phase II). Countries: Germany (ended).
Therapeutic area(s): Diseases [C] - Nervous System Diseases [C10]
Gender: Female, Male. Age: 18-64 years, 65+ years. Enrolment: 50.
Status: Ended. Start date (EU): 2023-03-21. End date (EU): 2025-12-04. Decision date: 2024-03-06. Results received: No. Last updated: 2024-08-22.

Condition(s): unresponsive wakefulness syndrome not otherwise explained
Product: Amantadin-ratiopharm® 200 mg Infusionslösung

Primary endpoint: A patient will bedefined as a responder if he/she improves by at least 3 points on the GCS after 5 days oftreatment at study visit 6
Endpoint(s): The secondary objective is Improvement of vigilance measured via alternative scales(Richmond Agitation-Sedation Scale (RASS), Full Outline of UnResponsiveness(FOUR) Score Coma Scale), Intensive Care Delirium Screening Checklist (ICDSC),National Institute of health Stroke Scale (NIHSS), modified Rankin Scale (mRS),Glasgow Outcome Scale – Extended (GOS-E), Coma Recovery Scale revised (CRSR)and Montreal Cognitive Assessment (MoCA) after 90 days, EEG results, survivaland clinical improvement r

Source: https://euclinicaltrials.eu/ctis-public/view/2024-512333-33-00